EU clinical trial 2024-511899-32-00: BIRD - Baricitinib in patients with relapsing or naive Dermatomyositis
Protocol code: APHP180612
Sponsor: Assistance Publique Hopitaux De Paris (Hospital/Clinic/Other health care facility). Phase: Phase II and Phase III (Integrated). Countries: France (ongoing, recruiting).
Therapeutic area(s): Diseases [C] - Immune System Diseases [C20]; Diseases [C] - Skin and Connective Tissue Diseases [C17]
Gender: Female, Male. Age: 18-64 years. Enrolment: 62.
Status: Ongoing, recruiting. Start date (EU): 2022-08-31. Decision date: 2024-09-13. Results received: No. Last updated: 2025-09-19.

Condition(s): Dermatomyositis; Baricitinib in patients with relapsing or naïve dermatomyositis.
Product: Olumiant 4 mg film-coated tablets, Placebo of Olumiant 4mg

Primary endpoint: moderate improvement (defined as a total improvement score superior or equal to 40 following ACR/EULAR definition) without corticosteroids at week 24 (prednisone-free moderate improvement).
Endpoint(s): -DM improvement at 5, 12 and 24 weeks in terms of: • minimal improvement (≥20 points total improvement ACR/EULAR), • moderate improvement (≥40 points total improvement ACR/EULAR) • major improvement (≥60 points total improvement ACR/EULAR), -Primary endpoint (prednisone-free moderate improvement at W24) in the following subgroups: • DM naive patients at baseline vs others • DM with a severe muscle weakness (MMT8 baseline <125/150) vs others, -Cutaneous disease activity and damage evaluated using the CDASI - Activity and CDASI damages at 5, 12 and 24 weeks, -Cumulative incidence of relapse and the time to first relapse, -Cumulative dose of corticosteroids, -Proportions of participants with an average prednisone dose of 0 mg per day, of more than 0 mg to not more than 4.0 mg per day, of more than 4.0 mg to not more than 7.5 mg per day, and of more than 7.5 mg per day during weeks 20 through 24., -Safety including the incidence, nature, and severity of adverse events and serious adverse events and laboratory abnormalities.

Source: https://euclinicaltrials.eu/ctis-public/view/2024-511899-32-00